EU clinical trial 2023-504322-19-00: Effect of acyclovir therapy on the outcome of ventilated patients with lower respiratory tract infection and detection of herpes simplex virus in bronchoalveolar lavage
Protocol code: ZKSJ0153
Sponsor: Friedrich Schiller Universitaet Jena (Educational Institution). Phase: Therapeutic confirmatory (Phase III). Countries: Germany (ongoing, recruiting).
Therapeutic area(s): Diseases [C] - Respiratory Tract Diseases [C08]; Diseases [C] - Virus Diseases [C02]
Gender: Female, Male. Age: 18-64 years, 65+ years. Enrolment: 710.
Status: Ongoing, recruiting. Start date (EU): 2024-01-10. Decision date: 2023-09-11. Results received: No. Last updated: 2026-05-05.

Condition(s): Patients in the intensive care unit on ventilation with pneumonia and detection of herpes simplex virus type 1 (HSV-1) in bronchoalveolar lavage (BAL).
Product: ACICLOVIR

Primary endpoint: 30-day mortality (Survival time)
Endpoint(s): Ventilation-free days up to day 30 (days without invasive ventilation via endotracheal tube, incl. tracheostoma as well as without non-invasive ventilation), Vasopressor-free days until day 30 (days without continuous vasopressor administration > 1h/day), Delta SOFA (Baseline - Day 10 or EOT), Delta SOFA sub-score kidney (baseline - day 10 or EOT), Delta GFR value (baseline - day 10 or EOT), Length of stay in ICU until day 30, Length of stay in Hospital until day 30, Cost of intervention (ICU and hospitalization days + acyclovir), Days without delirium/coma (based on CAM-ICU / RASS) until day 10/end of therapy, Microbiological cure (EOT) - HSV eradication for blood and respiratory tract respectively (no HSV detectable in PCR test at end of therapy), 90 days mortality, 180 days mortality, Quality of life (EQ5D-5L) day 10 or EOT, day 30, day 90, and day 180., Incidence SAEs

Source: https://euclinicaltrials.eu/ctis-public/view/2023-504322-19-00